EU clinical trial 2024-515954-26-00: A Phase 1, multiple-dose, single-center, randomized, open-label, 2-period, 2-treatment crossover systemic bioavailability study of diclofenac comparing XXX g (XXX mL) of AMZ001 (Diclofenac sodium gel XXX %) applied once daily (XXXXXXXXX) versus XXX g of Voltaren Emulgel 1.16% Gel (Diclofenac diethylamine gel 1.16%) applied 4 times daily (4 times 4 g on each knee) in healthy subjects
Protocol code: AMZ001-009
Sponsor: Amzell B.V. (Pharmaceutical company). Phase: Human Pharmacology (Phase I)- Other. Countries: Germany (ended).
Therapeutic area(s): Diseases [C] - Musculoskeletal Diseases [C05]
Gender: Female, Male. Age: 18-64 years, 65+ years. Enrolment: 34.
Status: Ended. Start date (EU): 2024-11-19. End date (EU): 2025-01-22. Decision date: 2024-11-04. Results received: No. Last updated: 2024-12-17.

Condition(s): Phase I Study in healthy male and female volunteers. Intended indication: acute and chronic musculoskeletal conditions

Source: https://euclinicaltrials.eu/ctis-public/view/2024-515954-26-00